EU clinical trial 2022-502850-14-00: A Phase 1 Study of PRT3789 in Participants with Advanced or Metastatic Solid Tumors with a SMARCA4 Mutation
Protocol code: PRT3789-01
Sponsor: Prelude Therapeutics Inc. (Pharmaceutical company). Phase: Human Pharmacology (Phase I)- First administration to humans. Countries: Spain (ended), France (ended), Netherlands (ended), Germany (ended).
Therapeutic area(s): Diseases [C] - Neoplasms [C04]
Gender: Female, Male. Age: 18-64 years, 65+ years. Enrolment: 70.
Status: Ended. Start date (EU): 2023-09-25. End date (EU): 2025-10-01. End date: 2025-10-02. Decision date: 2023-08-21. Results received: No. Last updated: 2025-07-29.
Decision dates by country: DE: 2025-02-07, FR: 2023-08-25, ES: 2023-08-21, NL: 2024-01-02

Condition(s): gastroesophageal junction, Skin Cancer/Melanoma, Lung Squamous cell carcinoma, Lung Adenocarcinoma, non-small cell lung cancer (NSCLC), Esophageal/gastric cancer, Ovarian Cancer, Bladder cancer, Colon adenocarcinoma, Uterine/Endometrioid Adenocarcinoma, Pancreatic Cancer, Breast Cancer, Head and Neck Squamous cell Carcinoma, gastrointestinal cancer

Source: https://euclinicaltrials.eu/ctis-public/view/2022-502850-14-00